EU clinical trial 2024-511687-90-00: Safety and Efficacy of a Unilateral Subretinal Administration of HORA PDE6B in Patients with Retinitis Pigmentosa Harbouring Mutations in the PDE6B Gene Leading to a Defect in PDE6ß Expression
Protocol code: HORA-PDE6B-001
Sponsor: eyeDNA Therapeutics (Pharmaceutical company). Phase: Phase I and Phase II (Integrated)- First administration to humans. Countries: France (ended).
Therapeutic area(s): Diseases [C] - Eye Diseases [C11]
Gender: Female, Male. Age: 0-17 years, 18-64 years. Enrolment: 23.
Status: Ended. Start date (EU): 2017-10-12. End date (EU): 2025-06-30. Decision date: 2024-05-17. Results received: No. Last updated: 2024-05-17.

Condition(s): retinitis pigmentosa
Product: ATROPINE 1 POUR CENT FAURE, collyre en solution en récipient unidose, CHIBRO CADRON, collyre en flacon, INDOCOLLYRE 0,1 %, collyre en solution en récipient unidose, Adenovirus associated viral vector serotype 5 containing the human pde6b gene, MYDRIASERT, insert ophtalmique, DEXAMETHASONE VIATRIS 4 mg/1 ml, solution injectable en ampoule

Primary endpoint: Primary endpoints will be the assessment of safety parameters: routine ophthalmic examination, intraocular inflammation, chorioretinal tolerance, questionnaire, vital signs, laboratory measurements
Endpoint(s): Functional tests: •distance and near visual acuity and refraction (near visual acuity not applicable for Cohort #4 patients); •colour vision; •visual fields; •global or full-field ERG; multifocal ERG*; •pupillometry (not applicable for the Cohort #3 & Cohort #4 patients); •microperimetry; •mobility test; •dark adaptation test; •full-field sensitivity threshold for the Cohort #3 & Cohort #4 patients; •evaluation of quality of life in adult patients, Morphologic tests: •fundus autofluorescence; •spectral domain optical coherence tomography (SD-OCT), Exploratory assessment: functional magnetic resonance imaging (fMRI)* * Not to be performed in Cohort #4

Source: https://euclinicaltrials.eu/ctis-public/view/2024-511687-90-00